EU clinical trial 2023-507263-19-00: A Randomized Phase 3 Study of MRTX849 versus Docetaxel in Patients with Previously Treated Non-Small Cell Lung Cancer with KRAS G12C Mutation
Protocol code: 849-012
Sponsor: Mirati Therapeutics Inc. (Pharmaceutical company). Phase: Therapeutic confirmatory (Phase III). Countries: Germany (ongoing, recruitment ended), Romania (ended), Hungary (ended), Italy (ongoing, recruitment ended), Czechia (ended), France (ongoing, recruitment ended), Poland (ongoing, recruitment ended), Belgium (ongoing, recruitment ended), Austria (ended), Ireland (ended), Portugal (ongoing, recruitment ended), Greece (ongoing, recruitment ended), Spain (ongoing, recruitment ended), Netherlands (ongoing, recruitment ended).
Therapeutic area(s): Diseases [C] - Respiratory Tract Diseases [C08]
Gender: Female, Male. Age: 18-64 years, 65+ years. Enrolment: 557.
Start date (EU): 2020-12-23. Decision date: 2024-07-11. Results received: No. Last updated: 2026-06-17.
Decision dates by country: CZ: 2024-07-16, RO: 2024-07-15, AT: 2024-07-16, ES: 2024-07-11, PL: 2024-08-04, FR: 2024-07-12, GR: 2024-09-25, PT: 2024-07-12, HU: 2024-07-15, BE: 2024-07-12, IE: 2024-07-11, IT: 2024-07-22, NL: 2024-07-16, DE: 2024-07-16

Condition(s): Advanced Non-Small Cell Lung Cancer
Product: DOCETAXEL, TAXOTERE 20 mg/0.5 ml concentrate and solvent for solution for infusion, DOCETAXEL, DOCETAXEL, Adagrasib, TAXOTERE 80 mg/4 ml concentrate for solution for infusion, TAXOTERE 20 mg/1 ml concentrate for solution for infusion

Primary endpoint: Progression-free Survival (PFS) Defined as time from randomization until disease progression or death from any cause, whichever occurs first.
Endpoint(s): Secondary efficacy endpoints:- Overall Survival (OS)− Objective Response Rate (ORR),− Duration of Response (DOR), and− 1-Year Survival Rate., Safety characterized by type, incidence, severity, timing, seriousness and relationship to study treatment of adverse events (AEs), laboratory abnormalities, and number of patients discontinuing study treatment due to an adverse event., Population PK parameters of MRTX849., Patient Reported Outcome (PRO) scores using the following:− Lung Cancer Symptom Scale (LCSS), and− European Quality of Life Five Dimensions Questionnaire(EQ-5D-5L).

Source: https://euclinicaltrials.eu/ctis-public/view/2023-507263-19-00